EU clinical trial 2023-505773-32-00: A Randomized, Phase 2/3 Study to Evaluate the Optimal Dose, Safety, and Efficacy of Livmoniplimab in Combination with Budigalimab Plus Chemotherapy Versus Pembrolizumab Plus Chemotherapy in Untreated Metastatic Non-Squamous Non-Small Cell Lung Cancer (NSCLC) – LIVIGNO-4
Protocol code: M23-721
Sponsor: AbbVie Deutschland GmbH & Co. KG (Pharmaceutical company). Phase: Phase II and Phase III (Integrated). Countries: France (ongoing, recruitment ended), Belgium (ongoing, recruitment ended), Spain (ongoing, recruitment ended), Netherlands (ongoing, recruitment ended).
Therapeutic area(s): Diseases [C] - Neoplasms [C04]
Gender: Female, Male. Age: 18-64 years, 65+ years. Enrolment: 57.
Status: Ongoing, recruitment ended. Start date (EU): 2025-03-25. Decision date: 2024-06-25. Results received: No. Last updated: 2026-08-06.
Decision dates by country: NL: 2024-07-01, BE: 2024-08-19, FR: 2024-07-01, ES: 2024-06-27

Condition(s): Untreated Metastatic Non-Squamous Non-Small Cell Lung Cancer, Untreated Metastatic Non-Squamous Non-Small Cell Lung Cancer, Untreated Metastatic Non-Squamous Non-Small Cell Lung Cancer, Untreated Metastatic Non-Squamous Non-Small Cell Lung Cancer
Product: KEYTRUDA 25 mg/mL concentrate for solution for infusion, Carboplatin 10 mg/ml Intravenous Infusion, Budigalimab, Pemetrexed medac 500 mg powder for concentrate for solution for infusion, Cisplatin 1mg/ml Injection BP, Livmoniplimab

Primary endpoint: Stage 1: Best Overall Response (BOR) of Complete Response (CR)/Partial Response (PR), Stage 2: Overall Survival (OS), Stage 1: Best Overall Response (BOR) of Complete Response (CR)/Partial Response (PR), Stage 2: Overall Survival (OS)
Endpoint(s): Stage 1: Progression Free Survival (PFS), Stage 1: Duration of Response (DOR), Stage 1: Overall Survival (OS), Stage 2: Progression Free Survival (PFS), Stage 2: Best Overall Response (BOR) of Complete Response (CR)/Partial Response (PR), Stage 2: Change from Baseline in Physical Functioning (PF) as measured by the PF domain of European Organization for Research Treatment of Cancer Quality of Life Questionnaire 17 (EORTC QLQ-F17), Stage 2: Change from Baseline in Non-Small Cell Lung Cancer Symptom Assessment Questionnaire (NSCLC-SAQ), Stage 2: Change from Baseline in Quality of Life as Measured by the Global Health Status/Quality of Life Domain of the EORTC QLQ-F17, Stage 2: Progression Free Survival per Investigator, Stage 1: Best Overall Response (BOR) of Complete Response (CR)/Partial Response (PR) per Investigator, Stage 2: Duration of Response (DOR), Stage 2: DOR per investigator, Stage 1: Progression Free Survival (PFS), Stage 1: Duration of Response (DOR), Stage 1: Overall Survival (OS), Stage 2: Progression Free Survival (PFS), Stage 2: Best Overall Response (BOR) of Complete Response (CR)/Partial Response (PR), Stage 2: Change from Baseline in Physical Functioning (PF) as measured by the PF domain of European Organization for Research Treatment of Cancer Quality of Life Questionnaire 17 (EORTC QLQ-F17), Stage 2: Change from Baseline in Non-Small Cell Lung Cancer Symptom Assessment Questionnaire (NSCLC-SAQ), Stage 2: Change from Baseline in Quality of Life as Measured by the Global Health Status/Quality of Life Domain of the EORTC QLQ-F17, Stage 2: Progression Free Survival per Investigator, Stage 1: Best Overall Response (BOR) of Complete Response (CR)/Partial Response (PR) per Investigator, Stage 2: Duration of Response (DOR), Stage 2: DOR per investigator

Source: https://euclinicaltrials.eu/ctis-public/view/2023-505773-32-00